EU clinical trial 2024-517572-38-00: Comparison of treatment with preservative-free dexamethasone 0.1% (Monofree Dexamethason) and diclofenac 0.1% (Dicloabak) eye drops versus preserved dexamethasone 0.1% (Maxidex) and diclofenac 0.1% (Voltaren Ophtha) eye drops after cataract surgery.
Sponsor: UZ Leuven (Hospital/Clinic/Other health care facility). Phase: Therapeutic use (Phase IV). Countries: Belgium (ended).
Therapeutic area(s): Analytical, Diagnostic and Therapeutic Techniques and Equipment [E] - Therapeutics [E02]
Gender: Female, Male. Age: 65+ years. Enrolment: 100.
Status: Ended. Start date (EU): 2018-10-03. End date (EU): 2025-11-18. Decision date: 2024-11-07. Results received: No. Last updated: 2024-11-07.

Condition(s): cataract
Product: Monofree Dexamethason 1 mg/ml, oogdruppels, oplossing in verpakking voor éénmalig gebruik, Dicloabak 1 mg/ml collyre en solution, MAXIDEX 1 mg/ml oogdruppels, suspensie, Voltaren ophtha 1 mg/ml Augentropfen

Primary endpoint: the primary endpoint will be the superiority of group without conservative (WC) on group with conservative (C) on aqueous flare value at week 4 after cataract surgery
Endpoint(s): tear osmolarity, conjunctival hyperemia, corneal fluorescein staining, tear-film breakup time, corneal sensitivity, central macular thickness, DEQ-5 score, inflammatory cytokine activities in tears, amount of tears, effect of conservatives on the ocular surface microbiome post cataract surgery

Source: https://euclinicaltrials.eu/ctis-public/view/2024-517572-38-00